EU clinical trial 2022-502984-39-00: A Multicentre, Randomised, Double-Blind, Parallel-Group Placebo-Controlled, Phase 3, Efficacy and Safety Study of Tezepelumab in 5 to < 12 Year Old Children with Severe Uncontrolled Asthma (HORIZON)
Protocol code: D5180C00016
Sponsor: AstraZeneca AB (Pharmaceutical company). Phase: Therapeutic confirmatory (Phase III). Countries: Spain (ongoing, recruiting), Poland (ongoing, recruiting), Hungary (ongoing, recruiting), France (ongoing, recruiting), Netherlands (authorised, recruiting), Italy (authorised, recruiting), Romania (ongoing, recruiting).
Therapeutic area(s): Diseases [C] - Respiratory Tract Diseases [C08]
Gender: Female, Male. Age: 0-17 years. Enrolment: 45.
Start date (EU): 2023-12-13. Decision date: 2023-12-05. Results received: No. Last updated: 2026-06-02.
Decision dates by country: HU: 2023-12-05, PL: 2023-12-06, FR: 2023-12-08, NL: 2023-12-11, RO: 2025-07-14, IT: 2025-08-05, ES: 2023-12-05

Condition(s): Severe Uncontrolled Asthma Asthma (an illness that causes breathing difficulty) that is not fully controlled, so that asthma attacks are still occurring despite the use of other available treatments
Product: TEZEPELUMAB, Matching placebo for Tezepelumab solution for injection

Primary endpoint: Annualised asthma exacerbation rate (AAER)
Endpoint(s): Change from baseline to Week 52 in pre-BD FEV1%PN., AAER associated with allergic asthma (as defined by a positive perennial allergen using serum specific IgE [FEIA])., Time to first severe asthma exacerbation., Proportion of participants with ≥ 1 severe asthma exacerbation., AAER associated with Emergency Room (ER) visit or hospitalisation., Cumulative exposure to systemic corticosteroids for treatment of severe asthma exacerbations during the 52-week double-blind Treatment period., Change from baseline to Week 52 in PAQLQ-(S)-IA total score., Change from baseline to Week 52 in weekly mean daily PASO reported diary., Change from baseline to Week 52 in ACQ-IA score., Change from baseline to Week 52 in Weekly mean rescue medication use and Weekly mean number of night-time awakenings., Change from baseline to Week 52 in biomarkers (blood eosinophil count, FeNO and total serum IgE)., Change from baseline to Week 52 pre-BD PEF., Asthma specific HRU (eg, unscheduled physician visits, unscheduled phone calls to physicians, use of other asthma medications)., Participant/caregiver health-related absences from work/school due to asthma., Serum concentrations of tezepelumab., Immunogenicity: Incidence of anti-drug antibodies and neutralising antibodies.

Source: https://euclinicaltrials.eu/ctis-public/view/2022-502984-39-00